EU clinical trial 2024-516333-12-00: A First-in-Human clinical trial assessing safety of ES2B-C001 with or without Montanide in patients with HER2 expressing metastatic breast cancer.
Protocol code: ES2B-C001-S01
Sponsor: Expres2ion Biotechnologies ApS (Pharmaceutical company). Phase: Human Pharmacology (Phase I)- First administration to humans. Countries: Austria (ongoing, recruiting).
Therapeutic area(s): Diseases [C] - Neoplasms [C04]
Gender: Female, Male. Age: 18-64 years, 65+ years. Enrolment: 40.
Status: Ongoing, recruiting. Start date (EU): 2024-12-16. Decision date: 2024-12-02. Results received: No. Last updated: 2026-03-27.

Condition(s): HER2 positive patients under HER2 maintenance therapy (metastatic or locally advanced, unresectable)

Source: https://euclinicaltrials.eu/ctis-public/view/2024-516333-12-00